EU clinical trial 2023-508959-39-00: A Multicenter, Randomized, Double-Blind, Placebo and Active Comparator Controlled Phase 3 Study in Patients with Moderate to Severe Plaque Psoriasis to Evaluate the Efficacy and Safety of ESK-001 (ONWARD2)
Protocol code: ESK-001-017
Sponsor: Alumis Inc. (Pharmaceutical company). Phase: Therapeutic confirmatory (Phase III). Countries: Poland (ended), Germany (ended), Spain (ended), Estonia (ended), Hungary (ended), France (ended), Latvia (ended), Romania (ended), Austria (ended).
Therapeutic area(s): Diseases [C] - Skin and Connective Tissue Diseases [C17]
Gender: Female, Male. Age: 18-64 years, 65+ years. Enrolment: 608.
Status: Ended. Start date (EU): 2025-02-20. End date (EU): 2025-12-18. End date: 2026-02-13. Decision date: 2025-01-21. Results received: No. Last updated: 2025-10-10.
Decision dates by country: RO: 2025-04-22, AT: 2025-01-27, HU: 2025-01-24, LV: 2025-01-24, DE: 2025-01-22, FR: 2025-01-21, EE: 2025-01-24, ES: 2025-01-22, PL: 2025-01-27

Condition(s): Moderate to Severe Plaque Psoriasis
Product: Otezla 10mg, 20mg, 30 mg film-coated tablets, Name: ESK-001 placebo Pharmaceutical form: film-coated tablet; Route of administration: oral use Maximum duration of treatment: 16 weeks, Otezla 30 mg film-coated tablets, Otezla 30 mg film-coated tablets, Name: apremilast placebo Pharmaceutical form: only over-encapsulating capsule shell containing backfill, no tablet Route of administration: oral use; Maximum duration of treatment: 16 weeks, ESK-001

Primary endpoint: The proportion of patients who achieve co-primary endpoint (PASI-75 & sPGA-0/1) at Week 16 compared with Placebo
Endpoint(s): Week 16 Endpoints: *The proportion of patients who achieve PASI-90, PASI-100, sPGA-0 PASI-75 and sPGA-0/1 compared to apremilast ss-PGA-0/1 PROs: PSSD-0 and DLQI-0/1 *Change from baseline in %BSA Pruritis NRS score, Week 24 Endpoints compared to apremilast: *The proportion of patients who achieve PASI-75, PASI-90, PASI-100 sPGA-0/1, sPGA-0 ss-PGA-0/1 PROs: PSSD-0 and DLQI-0/1 *Change from baseline %BSA Pruritis NRS score

Source: https://euclinicaltrials.eu/ctis-public/view/2023-508959-39-00